EU clinical trial 2025-521000-22-00: A clinical trial to learn about the effects of DAK539 on the blood levels of repaglinide, midazolam, drospirenone, and ethinyl estradiol in people with advanced cancer
Protocol code: CDAK539A12102
Sponsor: Novartis Pharma AG (Pharmaceutical company). Phase: Human Pharmacology (Phase I)- Other. Countries: Spain (ongoing, recruiting), Italy (authorised, recruitment pending), France (authorised, recruitment pending).
Therapeutic area(s): Diseases [C] - Neoplasms [C04]
Gender: Female, Male. Age: 18-64 years, 65+ years. Enrolment: 24.
Start date (EU): 2026-06-12. Decision date: 2026-04-14. Results received: No. Last updated: 2026-04-17.
Decision dates by country: FR: 2026-04-14, IT: 2026-04-15, ES: 2026-04-17

Condition(s): Patients with advanced malignancies

Source: https://euclinicaltrials.eu/ctis-public/view/2025-521000-22-00